EU clinical trial 2024-512164-63-00: New therapeutic approach to Toxic Epidermal Necrolysis (TEN) using anti-CD38+ antibodies in the active phase of the disease – Phase I/II study to assess the tolerance and efficacy of DARATUMUMAB - NET-CD38 Study
Protocol code: 69HCL23_1000
Sponsor: Hospices Civils De Lyon (Hospital/Clinic/Other health care facility). Phase: Phase I and Phase II (Integrated)- Other. Countries: France (authorised, recruitment pending).
Therapeutic area(s): Diseases [C] - Skin and Connective Tissue Diseases [C17]
Gender: Female, Male. Age: 18-64 years, 65+ years. Enrolment: 9.
Status: Authorised, recruitment pending. Decision date: 2025-04-29. Results received: No. Last updated: 2025-04-29.

Condition(s): Toxic Epidermal Necrolysis

Source: https://euclinicaltrials.eu/ctis-public/view/2024-512164-63-00